EU clinical trial 2023-506877-37-00: A Phase III, Multicenter, Open-Label, Randomized Study to Evaluate the Efficacy and Safety of Belantamab Mafodotin in Combination with Pomalidomide and Dexamethasone (B-Pd) versus Pomalidomide plus Bortezomib and Dexamethasone (PVd) in Participants with Relapsed/Refractory Multiple Myeloma (DREAMM 8)
Protocol code: 207499
Sponsor: Glaxosmithkline Research & Development Limited (Pharmaceutical company). Phase: Therapeutic confirmatory (Phase III). Countries: Czechia (ongoing, recruitment ended), Greece (ongoing, recruitment ended), Germany (ongoing, recruitment ended), Poland (ongoing, recruitment ended), France (ongoing, recruitment ended), Italy (ongoing, recruitment ended), Spain (ongoing, recruitment ended).
Therapeutic area(s): Diseases [C] - Neoplasms [C04]
Gender: Female, Male. Age: 18-64 years, 65+ years. Enrolment: 148.
Status: Ongoing, recruitment ended. Start date (EU): 2020-09-28. Decision date: 2024-07-08. Results received: No. Last updated: 2026-02-10.
Decision dates by country: IT: 2024-08-05, GR: 2024-08-20, PL: 2024-07-15, DE: 2024-07-09, ES: 2024-07-08, FR: 2024-07-22, CZ: 2024-07-09

Condition(s): Relapsed/Refractory Multiple Myeloma
Product: Imnovid 3 mg hard capsules, Imnovid 4 mg hard capsules, Dexamethasone Tablets BP 2.0mg, Dexamethason 8 mg GALEN® Tabletten, Imnovid 2 mg hard capsules, Dexamethason 8 mg JENAPHARM®, Dexamethasone 2mg Tablets, Imnovid 1 mg hard capsules, VELCADE 3.5 mg powder for solution for injection

Primary endpoint: Progression-Free Survival (PFS), defined as the time from randomization until the earliest date of PD based on IRC-assessment per IMWG criteria, or death due to any caus
Endpoint(s): Overall Survival (OS), defined as the interval of time from randomization to the date of death due to any cause, Duration of Response (DoR), defined as the time from first documented evidence of PR or better until progressive disease (PD) or death due to any progressive disease (PD) or death due to any per IMWG criteria. MRD negativity rate, defined as the percentage of participants who achieve MRD negative status (as assessed by NGS at 10-5 threshold) at least once during the time of confirmed CR or better response based on IRC-assessment per IMWG, Overall Response Rate (ORR,), defined as the percentage of participants with a confirmed partial response (PR) or better (i.e., PR, VGPR, CR, and sCR) based on IRC-assessment per IMWG criteria, Complete Response Rate (CRR,), defined as the percentage of participants with a confirmed complete response (CR) or better (i.e., CR and stringent complete response (sCR))) based on IRC assessment per IMWG criteria, Very Good Partial Response (VGPR) or better rate, defined as the percentage of participants with a confirmed VGPR or better (i.e., VGPR, CR, and sCR) based on IRC-assessment per IMWG criteria, Time to Best Response (TTBR), defined as the interval of time between the date of randomization and the earliest date of achieving best response among participants with a confirmed PR or better based on IRC-assessment per IMWG, Time to Response (TTR), defined as the time between the date of randomization and the first documented evidence of response (PR or better) among participants who achieve a response (i.e., confirmed PR or better) based on IRC-assessment per IMWG, Time to Progression (TTP), defined as the time from randomization until the earliest date of PD based on IRC-assessment per IMWG criteria, or death due to PD, PFS2, defined as time from randomization to disease progression (investigator-assessed response) after initiation of new anti-myeloma therapy or death from any cause, whichever is earlier. If disease progression after new antimyeloma therapy cannot be measured, a PFS event is defined as the date of discontinuation of new anti-myeloma therapy, or death from any cause, whichever is earlie, Incidence of AEs and changes in laboratory parameters, Ocular findings on ophthalmic exam, Plasma concentrations of belantamab mafodotin and cys-mcMMAF, Derived PK parameter values, as data permit, Incidence and titers of ADAs against belantamab mafodotin, Maximum post-baseline PRO-CTCAE score or each item attribute, Change from baseline in HRQOL as measured by EORTC QLQ-C30, EORT QLQ-MY20 and EORTC IL52

Source: https://euclinicaltrials.eu/ctis-public/view/2023-506877-37-00